EU clinical trial 2023-508852-21-00: A Phase II, Open-label, Multicentre, Randomised Study of Neoadjuvant and Adjuvant Treatment in Patients with Resectable, Early-stage (II to IIIB) Non-small Cell Lung Cancer (NeoCOAST-2)
Protocol code: D9077C00001
Sponsor: AstraZeneca AB (Pharmaceutical company). Phase: Therapeutic exploratory (Phase II). Countries: Hungary (ongoing, recruiting), Portugal (ongoing, recruiting), Belgium (ongoing, recruiting), France (ongoing, recruiting), Italy (ongoing, recruiting), Spain (ongoing, recruiting), Ireland (ongoing, recruiting).
Therapeutic area(s): Diseases [C] - Neoplasms [C04]
Gender: Female, Male. Age: 18-64 years, 65+ years. Enrolment: 493.
Status: Ongoing, recruiting. Start date (EU): 2022-06-10. Decision date: 2024-10-02. Results received: No. Last updated: 2026-04-17.
Decision dates by country: BE: 2024-10-07, FR: 2024-10-04, HU: 2024-10-02, IE: 2024-10-03, IT: 2024-10-30, PT: 2024-10-04, ES: 2024-10-15

Condition(s): Resectable, Early-stage (II to IIIB) Non-small Cell Lung Cancer
Product: Inflectra 100 mg powder for concentrate for solution for infusion, Inflectra 100 mg powder for concentrate for solution for infusion, AZD0171, Oleclumab, Mycophenolate Mofetil 250 mg Capsules, Inflectra 100 mg powder for concentrate for solution for infusion, CARBOPLATIN, IMFINZI 50 mg/mL concentrate for solution for infusion., volrustomig, CISPLATIN, Monalizumab, Datopotamab deruxtecan, Inflectra 100 mg powder for concentrate for solution for infusion, Rilvegostomig, Inflectra 100 mg powder for concentrate for solution for infusion, PACLITAXEL, PEMETREXED

Primary endpoint: pCR is defined as lack of any viable tumour cells after complete evaluation in the resected lung cancer specimen and all sampled regional lymph nodes as determined by central BIPR and described by IASLC 2020. The measure of interest is the proportion of patients with 0% residual viable tumour cells within all resected tissue as assessed by the central blinded pathologist., Safety and tolerability will be evaluated in terms of AEs, vital signs, and clinical laboratory parameters.
Endpoint(s): EFS is defined as the time from randomisation to the first of the following: local or distant disease recurrence, progressive disease that precludes surgery or prevents completion of surgery, or death due to any cause., DFS is defined as the time from surgery until the first of the following: local or distant disease recurrence or date of death due to any cause., Feasibility to surgery is defined as having the planned surgical resection within 40 days from the end of the last dose of neoadjuvant study interventions. The measure of interest is the proportion of patients that have intended surgery within 40 days from the end of last dose of neoadjuvant study interventions., mPR is defined as ≤ 10% viable tumour cells in resected tumour after complete evaluation in the resected lung cancer specimen as determined by central BIPR as described by IASLC 2020. The measure of interest is the proportion of patients with ≤ 10% residual viable tumour cells within all resected tissue as assessed by the central blinded pathologist., ORR is defined as the proportion of patients who have a CR or PR as determined by Investigator using RECIST 1.1. Patients who go off therapy prior to surgery, without a response, receive a subsequent therapy prior to surgery, and then respond will not be included as responders in the ORR. The measure of interest is the proportion of patients with OR., OS is defined as the time from randomisation until the date of death due to any cause. The measure of interest is the landmark OS at 12 months and 24 months, and other clinically relevant timepoints if feasible. If reached by the end of the study, the median OS will also be of interest., Concentration of study interventions in plasma or serum., Presence of ADA for study interventions., Baseline PD-L1 expression., ctDNA clearance on-treatment prior to surgery.

Source: https://euclinicaltrials.eu/ctis-public/view/2023-508852-21-00